EU clinical trial 2023-503843-33-00: A Phase 3, Multicenter, Open Label Study to Confirm the Diagnostic Potential of Intravenously Administered 15O- H2O to Identify Coronary Artery Disease During Pharmacological Stress and Resting Conditions Using PET Imaging
Protocol code: MedTrace-002
Sponsor: MedTrace Pharma A/S (Pharmaceutical company). Phase: Therapeutic confirmatory (Phase III). Countries: Denmark (ongoing, recruitment ended), Sweden (ongoing, recruitment ended), Germany (ongoing, recruitment ended), Netherlands (ongoing, recruitment ended).
Therapeutic area(s): Diseases [C] - Cardiovascular Diseases [C14]
Gender: Female, Male. Age: 18-64 years, 65+ years. Enrolment: 160.
Status: Ongoing, recruitment ended. Start date (EU): 2022-05-04. Decision date: 2023-05-09. Results received: No. Last updated: 2026-04-01.
Decision dates by country: NL: 2025-09-25, DE: 2025-02-07, DK: 2023-05-09, SE: 2024-02-27

Condition(s): Coronary Artery Disease
Product: O15-Water

Primary endpoint: The primary efficacy endpoints of the study are the sensitivity and specificity of 15O-H2O Injection PET MPI in the detection of significant CAD. The truth standard used in this study is the presence of clinically significant CAD as assessed by either ICA, ICA with FFR or CCTA.

Source: https://euclinicaltrials.eu/ctis-public/view/2023-503843-33-00